EU clinical trial 2024-512350-17-01: COATS (genetic Clopidogrel response testing to finetune the antithrombotic regimen in (D)OAC Treated patients undergoing PCI) Study
Protocol code: NL77315.078.21
Sponsor: Erasmus Universitair Medisch Centrum Rotterdam (Erasmus MC) (Hospital/Clinic/Other health care facility). Phase: Therapeutic use (Phase IV). Countries: Netherlands (authorised, recruitment pending).
Therapeutic area(s): Analytical, Diagnostic and Therapeutic Techniques and Equipment [E] - Diagnosis [E01]; Diseases [C] - Cardiovascular Diseases [C14]
Gender: Female, Male. Age: 18-64 years, 65+ years. Enrolment: 520.
Status: Authorised, recruitment pending. Decision date: 2024-09-13. Results received: No. Last updated: 2024-09-13.

Condition(s): Patients with coronary artery disease and an indication for PCI
Product: Brilique 90 mg film-coated tablets, Clopidogrel Medreg 75 mg filmom obalené tablety

Primary endpoint: Primary safety endpoint: Major and CRNM bleeding at 12 months, compared to an objective performance goal (OPG) derived from a meta-analysis of five contemporary (D)OAC + PCI studies, estimated at 14.1%., Primary efficacy endpoint: composite of all-cause mortality, myocardial infarction, stroke and stent thrombosis at 12 months, compared to an OPG of 10.1% for (D)OAC + P2Y12 treated patients.
Endpoint(s): Safety evaluation in study subgroups: major and CRNM bleeding at 12 months, compared between the 4 study groups (ACS/ticagrelor vs ACS/clopidogrel vs elective/ticagrelor vs elective/clopidogrel)., Efficacy evaluation in study subgroups: composite of all-cause mortality, myocardial infarction, stroke and stent thrombosis at 12 months, compared between the 4 study groups (ACS/ticagrelor vs ACS/clopidogrel vs elective/ticagrelor vs elective/clopidogrel)., EQ5D5L questionnaire: a descriptive survey that produces a 5-digit health state profile that represents a level of reported problems for five dimensions of health, to make comparisons between aforementioned patient groups.

Source: https://euclinicaltrials.eu/ctis-public/view/2024-512350-17-01